EU clinical trial 2024-513691-18-00: A Phase IIb Randomized, Double-blind, Placebo-controlled Study to Evaluate the Efficacy, Safety and Tolerability of AZD5004 in Participants Living with Obesity or Overweight with Comorbidity
Protocol code: D7260C00001
Sponsor: AstraZeneca AB (Pharmaceutical company). Phase: Therapeutic exploratory (Phase II). Countries: Germany (ended).
Therapeutic area(s): Diseases [C] - Nutritional and Metabolic Diseases [C18]
Gender: Female, Male. Age: 18-64 years, 65+ years. Enrolment: 30.
Status: Ended. Start date (EU): 2024-12-11. End date (EU): 2025-11-20. End date: 2025-11-21. Decision date: 2024-10-14. Results received: No. Last updated: 2025-11-24.
Decision dates by country: DE: 2025-01-03

Condition(s): Participants living with Obesity or Overweight with at least 1 comorbidity
Product: AZD5004, Placebo to match AZD5004 film coated tablet, AZD5004, AZD5004

Primary endpoint: Percent change in body weight from baseline at Week 26, Proportion of participants with weight loss ≥ 5% from baseline weight at Week 26
Endpoint(s): Percent change in body weight from baseline at Week 36, Proportion of participants with weight loss ≥ 5% at Week 36, Absolute change from baseline in body weight at Week 26 and at Week 36, Proportion of participants with weight loss ≥ 10% as well as ≥ 15% at Week 26 and at Week 36

Source: https://euclinicaltrials.eu/ctis-public/view/2024-513691-18-00